EU clinical trial 2024-513328-40-00: SHORTCUT - Efficacy of 7 days versus 14 days of antibiotic therapy for acute pyelonephritis in kidney transplant recipients, a multicenter randomized non-inferiority trial
Protocol code: APHP200020
Sponsor: Assistance Publique Hopitaux De Paris (Hospital/Clinic/Other health care facility). Phase: Therapeutic use (Phase IV). Countries: France (ongoing, recruiting).
Therapeutic area(s): Diseases [C] - Bacterial Infections and Mycoses [C01]; Diseases [C] - Male Urogenital Diseases [C12]; Diseases [C] - Female Urogenital Diseases and Pregnancy Complications [C13]
Gender: Female, Male. Age: 18-64 years, 65+ years. Enrolment: 470.
Status: Ongoing, recruiting. Start date (EU): 2024-03-25. Decision date: 2024-06-19. Results received: No. Last updated: 2026-05-04.

Condition(s): Pyelonephritis, Kidney Transplant recipients
Product: SULFAMETHOXAZOLE AND TRIMETHOPRIM

Primary endpoint: Clinical cure and no additional antibiotic treatment since the end of antibiotic treatment up to the main evaluation at day 30. Clinical cure is defined as fever <38°C and no symptoms of UTI.
Endpoint(s): Clinical cure at day 90 and 180, Microbiological cure *at day 30, 90 and 180, Incidence of relapse /recurrence between day 30 and day 90, Incidence of adverse events imputable to antibiotic treatment, Kidney function assessed according to MDRD (Modification of Diet in Renal Disease) or CKD (Chronic Kidney Disease - Epidemiology Collaboration) epi, Hospitalization length stay defined by the delay between the date of inclusion and the date of hospital discharge, Antibiotic consumption, Rectal carriage of antibiotic resistant Enterobacteriaceae at inclusion and day 30

Source: https://euclinicaltrials.eu/ctis-public/view/2024-513328-40-00